EU clinical trial 2025-524150-34-00: A Study to Learn How Different Amounts of the Study Intervention Called PF-07832837 are Tolerated and Act in the Body in Healthy Adults and Patients
Protocol code: C4991001
Sponsor: Pfizer Inc. (Pharmaceutical company). Phase: Human Pharmacology (Phase I)- First administration to humans. Countries: Poland (authorised, recruitment pending).
Therapeutic area(s): Diseases [C] - Skin and Connective Tissue Diseases [C17]
Gender: Female, Male. Age: 18-64 years, 65+ years. Enrolment: 19.
Status: Authorised, recruitment pending. Decision date: 2026-06-18. Results received: No. Last updated: 2026-06-18.

Condition(s): Atopic Dermatitis

Source: https://euclinicaltrials.eu/ctis-public/view/2025-524150-34-00